EU clinical trial 2024-515181-14-00: Postoperative anti-infective strategy following pancreaticoduodenectomy in patients with preoperative biliary stent FRENCH24 ANIS
Protocol code: 2020/0423/HP
Sponsor: Centre Hospitalier Universitaire Rouen (Hospital/Clinic/Other health care facility). Phase: Therapeutic confirmatory (Phase III). Countries: France (ongoing, recruiting).
Therapeutic area(s): Diseases [C] - Digestive System Diseases [C06]
Gender: Female, Male. Age: 18-64 years, 65+ years. Enrolment: 326.
Status: Ongoing, recruiting. Start date (EU): 2026-05-20. Decision date: 2024-09-12. Results received: No. Last updated: 2026-05-07.

Condition(s): Patients with preoperative biliary stent treated by pancreaticoduodenectomy
Product: PIPERACILLINE/TAZOBACTAM KABI 4 g/ 500 mg, poudre pour solution pour perfusion.

Primary endpoint: The primary endpoint is the presence of organ/space SSI determined according to the Centers for Disease Control and Prevention’s national nosocomial infections surveillance system. Organ/space SSIs included postoperative pancreatic fistula (POPF) and bile leakage, with positive culture results.
Endpoint(s): Infectious complications at post-operative day 90 Overall postsurgical morbidity, graded according to the Dindo/Clavien classification and CCI score at post operative day 90 Specific morbidity due to pancreatic fistula, graded according to the International Study Group of Pancreatic Fistula (ISGPF) criteria Readmission rates at post-operative day 90 Duration of hospitalization, Correlation between post-operative bacteriological samples and intraoperative bile samples, Bacteriological resistance profiles, Incidence of fungal contamination, Correlation between bacteriological and fungal contaminations, Incremental cost per infectious complications avoided

Source: https://euclinicaltrials.eu/ctis-public/view/2024-515181-14-00